EU clinical trial 2025-520788-42-00: A PHASE 2 OPEN LABEL STUDY OF ORAL LORLATINIB (PF-06463922) IN PATIENTS WITH RELAPSED ALK POSITIVE LYMPHOMA PREVIOUSLY TREATED WITH ALK INHIBITORS
Protocol code: CRU3
Sponsor: Universita Degli Studi Di Milano Bicocca (Educational Institution). Phase: Therapeutic exploratory (Phase II). Countries: Italy (ended).
Therapeutic area(s): Diseases [C] - Neoplasms [C04]
Gender: Female, Male. Age: 18-64 years, 65+ years. Enrolment: 12.
Status: Ended. Start date (EU): 2019-09-26. End date (EU): 2025-12-31. Decision date: 2025-01-31. Results received: No. Last updated: 2025-11-04.

Condition(s): Anaplastic Large Cells Lymphoma (ALCL) ALK+
Product: Lorviqua 25 mg film-coated tablets

Primary endpoint: ORR
Endpoint(s): PFS, OS, Toxicity, QoL, Mutational analysis

Source: https://euclinicaltrials.eu/ctis-public/view/2025-520788-42-00